EU clinical trial 2024-520337-80-00: A phase 3, randomized, double-blind, placebo-controlled, multicenter study with open-label extension to evaluate the efficacy and safety of bimekizumab in study participants with palmoplantar pustulosis
Protocol code: PPP001
Sponsor: UCB Biopharma (Pharmaceutical company). Phase: Therapeutic confirmatory (Phase III). Countries: Czechia (ongoing, recruiting), Denmark (ongoing, recruiting), Spain (ongoing, recruiting), Poland (ongoing, recruiting), Germany (ongoing, recruiting), Hungary (ongoing, recruiting), Italy (authorised, recruitment pending), France (ongoing, recruiting).
Therapeutic area(s): Diseases [C] - Immune System Diseases [C20]
Gender: Female, Male. Age: 18-64 years, 65+ years. Enrolment: 190.
Start date (EU): 2026-01-07. Decision date: 2025-12-02. Results received: No. Last updated: 2025-12-17.
Decision dates by country: CZ: 2025-12-02, DK: 2025-12-02, FR: 2025-12-02, IT: 2025-12-04, ES: 2025-12-09, DE: 2025-12-10, HU: 2025-12-11, PL: 2025-12-17

Condition(s): Palmoplantar Pustulosis
Product: Bimzelx 160 mg solution for injection in pre-filled syringe, Bimzelx 160 mg solution for injection in pre-filled syringe, Bimzelx 320 mg solution for injection in pre-filled pen, Bimzelx 320 mg solution for injection in pre-filled pen, Placebo matching test. 0.9% sodium chloride solution for injection (unauthorized)., Bimzelx 160 mg solution for injection in pre-filled syringe, Bimzelx 160 mg solution for injection in pre-filled syringe

Primary endpoint: Palmoplantar pustulosis-Investigator Global Assessment 0/1 (PPP-IGA 0/1) response at Week 16
Endpoint(s): Palmoplantar Pustulosis Area Severity Index 50 (PPPASI50) response at Week 16, PPPASI75 response at Week 16, PPPASI90 response at Week 16, PPPASI50 response at Week 8, PPP-IGA 0/1 response at Week 8, Change from Baseline in Dermatology Life Quality Index (DLQI) total score at Week 16, Change from Baseline in Numerical Rating Scale (NRS) – PPP Pain score in the palmoplantar areas at Week 16, Incidence of treatment-emergent adverse events (TEAEs) from Baseline to the end of the Safety Follow-up (SFU) Period, Incidence of serious TEAEs from Baseline to the end of the SFU Period, Incidence of TEAEs leading to permanent discontinuation of study treatment from Baseline to the end of the SFU Period

Source: https://euclinicaltrials.eu/ctis-public/view/2024-520337-80-00